EU clinical trial 2025-522754-39-00: Duration of Surfactant administration and impact on Stabilisation of vital parameters in very preterm neonates: 1 minute versus 5 minutes – a prospective randomised-controlled phase IV trial
Sponsor: Medical University Of Graz (Educational Institution). Phase: Therapeutic use (Phase IV). Countries: Austria (ongoing, recruiting).
Therapeutic area(s): Diseases [C] - Respiratory Tract Diseases [C08]
Gender: Female, Male. Age: 0-17 years. Enrolment: 76.
Status: Ongoing, recruiting. Start date (EU): 2026-02-24. Decision date: 2025-12-01. Results received: No. Last updated: 2026-02-16.

Condition(s): Neonatal respiratory distress syndrome
Product: Curosurf® 120 mg Suspension zur endotracheopulmonalen Instillation, Curosurf® 240 mg Suspension zur endotracheopulmonalen Instillation

Primary endpoint: Vital parameters (SpO2, HR and crSO2) during surfactant administration; defined as maximum changes/drop from baseline starting with the beginning of the surfactant administration after insertion of the thin catheter till 15 minutes after the LISA procedure.
Endpoint(s): SpO2, HR, crSO2 and MABP up to three hours after surfactant administration; defined as maximum changes/drop from baseline starting with the beginning of the surfactant administration after insertion of the thin catheter till three hours after LISA procedure., Need of supplemental oxygen, the amount of bradycardia and hypoxia (in minutes); up to three hours after surfactant administration., Vital parameters until three hours after extubation, assessed every five minutes., Need for a second/repetitive dose of surfactant, Invasive ventilation during the first two days after initial surfactant administration., short-term outcome (morbidity) until discharge or term age dependent on what comes first.

Source: https://euclinicaltrials.eu/ctis-public/view/2025-522754-39-00